EU clinical trial 2023-503665-39-00: Phase 2 Study of Futibatinib 20 mg and 16 mg in Patients with Advanced Cholangiocarcinoma with FGFR2 Fusions or Rearrangements
Protocol code: TAS-120-205
Sponsor: Taiho Oncology Inc. (Pharmaceutical company). Phase: Therapeutic exploratory (Phase II). Countries: Spain (ongoing, recruitment ended), Italy (ongoing, recruitment ended), Portugal (ended), Poland (ongoing, recruitment ended).
Therapeutic area(s): Diseases [C] - Neoplasms [C04]
Gender: Female, Male. Age: 18-64 years, 65+ years. Enrolment: 41.
Start date (EU): 2023-11-14. Decision date: 2023-10-19. Results received: No. Last updated: 2026-06-25.
Decision dates by country: PL: 2023-11-09, PT: 2023-10-27, ES: 2023-10-19, IT: 2023-10-25

Condition(s): Advanced cholangiocarcinoma
Product: Futibatinib

Primary endpoint: ORR by independent central review defined as the proportion of patients experiencing a best overall response ofpartial response (PR) or complete response (CR) (per RECIST 1.1), based on ICR"
Endpoint(s): Duration of response (DoR) by BICR, Progression-free survival (PFS) by BICR, ORR, DoR, and PFS by investigator assessment, Overall survival (OS), Safety based on AEs (in particular ≥Grade 3), SAEs, dose modifications, clinical laboratory parameters, ophthalmological exams, and vital signs, PROs measured by the European Organization for Research and Treatment of Cancer (EORTC) QLQ-C30 and the EuroQol-5D (EQ-5D)

Source: https://euclinicaltrials.eu/ctis-public/view/2023-503665-39-00